EU clinical trial 2026-526494-42-00: Diagnostic Efficacy of 18F-FAPI-74 PET/CT in Patients with Gastric Cancer
Sponsor: Varsinais-Suomen hyvinvointialue (Hospital/Clinic/Other health care facility). Phase: Therapeutic exploratory (Phase II). Countries: Finland (authorised, recruitment pending).
Therapeutic area(s): Diseases [C] - Neoplasms [C04]
Gender: Female, Male. Age: 18-64 years, 65+ years. Enrolment: 80.
Status: Authorised, recruitment pending. Decision date: 2026-06-05. Results received: No. Last updated: 2026-06-05.

Condition(s): Gastric cancer
Product: [18F]FAPI-74

Primary endpoint: The primary variable of this study is to demonstrate the detection rates of the primary tumor, metastatic lymph nodes and distant metastases in gastric cancer with 18F-FAPI-74 PET/CT
Endpoint(s): Secondary variable is to demonstrate the detection of distant metastases with 18F-FAPI-74 PET/CT. PET findings are compared to the gold standard of histopathological findings, or in recurrent disease to histopathological findings or routine clinical follow-up CT in one year.

Source: https://euclinicaltrials.eu/ctis-public/view/2026-526494-42-00